EU clinical trial 2022-502887-19-00: R-MINI-CHOP versus R-MINI-CHP in combination with polatuzumab-vedotin, as primary treatment for patients with diffuse large B-cell lymphoma, ≥80 years, or frail ≥75 years – an open label randomized Nordic Lymphoma Group phase III trial - NLG-LBC7 (POLAR BEAR)
Protocol code: NLG-LBC7
Sponsor: Region Skane (Hospital/Clinic/Other health care facility). Phase: Therapeutic confirmatory (Phase III). Countries: Norway (ongoing, recruitment ended), Sweden (ongoing, recruitment ended), Denmark (ongoing, recruitment ended), Finland (ongoing, recruitment ended), Italy (ongoing, recruitment ended), Estonia (authorised, recruitment pending).
Therapeutic area(s): Diseases [C] - Neoplasms [C04]; Diseases [C] - Hemic and Lymphatic Diseases [C15]
Gender: Female, Male. Age: 65+ years. Enrolment: 259.
Start date (EU): 2020-08-18. Decision date: 2023-07-26. Results received: No. Last updated: 2026-02-11.
Decision dates by country: NO: 2023-07-31, SE: 2023-07-26, DK: 2023-07-27, FI: 2023-07-27, IT: 2023-08-02, EE: 2025-05-08

Condition(s): Diffuse Large B-Cell Lymphoma
Product: CYCLOPHOSPHAMIDE, RITUXIMAB, PREDNISONE, Polivy 140 mg powder for concentrate for solution for infusion, VINCRISTINE SULFATE, RITUXIMAB, DOXORUBICIN HYDROCHLORIDE

Primary endpoint: Progression-free survival
Endpoint(s): Response duration, Complete remission rate, Overall response rate, Health-related quality of life, Overall survival, Lymphoma-specific survival, Safety

Source: https://euclinicaltrials.eu/ctis-public/view/2022-502887-19-00